EU clinical trial 2025-520688-42-00: A Phase IIb Randomized, Double-blind, Placebo-controlled, Multi-Dose Study to Evaluate the Effects of PHENOGENE-1a (Cromolyn) as an Adjuvant Treatment in Subjects with Mild to Moderate Amyotrophic Lateral Sclerosis (ALS)
Protocol code: PHENOALS-001
Sponsor: Phenonet Inc. (Pharmaceutical company). Phase: Therapeutic exploratory (Phase II). Countries: Germany (ongoing, recruiting), Czechia (ongoing, recruiting), Poland (ongoing, recruiting), Spain (ongoing, recruiting).
Therapeutic area(s): Diseases [C] - Nervous System Diseases [C10]
Gender: Female, Male. Age: 18-64 years, 65+ years. Enrolment: 128.
Status: Ongoing, recruiting. Start date (EU): 2026-01-27. Decision date: 2025-10-21. Results received: No. Last updated: 2026-06-09.
Decision dates by country: ES: 2025-10-23, PL: 2025-10-26, DE: 2025-10-21, CZ: 2025-10-22

Condition(s): Amyotrophic Lateral Sclerosis (ALS)
Product: PHENOGENE-1a, Placebo capsule, oral inhalation via DPI

Primary endpoint: Absolute change in ALSFRS-R total score from baseline to Week 24.
Endpoint(s): Mean rank for CAFS across all by treatment group at Week 24., Time to event requiring full-time or nearly full-time respiratory support., Mean change in %FVC from baseline to Week 24., Mean change in PIFR from baseline to Week 24.

Source: https://euclinicaltrials.eu/ctis-public/view/2025-520688-42-00